EU clinical trial 2025-520494-40-00: Neurogenic inflammation upon AITC-induced TRPA1 activation
Protocol code: S70063
Sponsor: UZ Leuven (Hospital/Clinic/Other health care facility). Phase: Human Pharmacology (Phase I)- Other. Countries: Belgium (ended).
Therapeutic area(s): Phenomena and Processes [G] - Physiological processes [G07]
Gender: Male. Age: 18-64 years. Enrolment: 25.
Status: Ended. Start date (EU): 2025-03-04. End date (EU): 2026-04-21. Decision date: 2025-02-26. Results received: No. Last updated: 2026-04-03.

Condition(s): Not applicable; this trial investigates a physiological process in healthy volunteers.

Source: https://euclinicaltrials.eu/ctis-public/view/2025-520494-40-00